EU clinical trial 2024-516066-11-00: Niraparib vs Niraparib in combination with Bevacizumab in patients with carboplatinum-taxane based chemotherapy in advanced ovarian cancer (A multicentre randomised phase III trial)
Protocol code: AGO-OVAR 28
Sponsor: AGO Research GmbH (Pharmaceutical company). Phase: Therapeutic confirmatory (Phase III). Countries: Germany (ongoing, recruiting), Belgium (authorised, recruitment pending), Czechia (authorised, recruitment pending), Italy (authorised, recruitment pending).
Therapeutic area(s): Diseases [C] - Neoplasms [C04]
Gender: Female. Age: 18-64 years, 65+ years. Enrolment: 1103.
Start date (EU): 2022-08-31. Decision date: 2024-12-02. Results received: No. Last updated: 2026-06-05.
Decision dates by country: BE: 2026-04-30, CZ: 2026-05-21, IT: 2026-05-15, DE: 2024-12-02

Condition(s): Patients with newly diagnosed, histologically confirmed, primary advanced invasive high grade epithelial ovarian cancer, peritoneal cancer, or fallopian tube cancer, FIGO stage III/IV (except FIGO IIIA2 without nodal involvement), with indication for a platin/paclitaxel chemotherapy, who have either undergone upfront primary surgery or plan to undergo chemotherapy with interval debulking surgery (IDS)
Product: Carboplatin Kabi 10 mg/ml Konzentrat zur Herstellung einer Infusionslösung, Zejula 100 mg hard capsules, Paclitaxel-GRY® 6 mg/ml Konzentrat zur Herstellung einer Infusionslösung, Avastin 25 mg/ml concentrate for solution for infusion., Zejula 100 mg film-coated tablets

Primary endpoint: PFS will be defined as the time from randomization to first progressive disease (PD) or death, whichever occurs earlier. PD is based on investigators assessment using the Response Evaluation Criteria in Solid Tumors (RECIST v1.1).
Endpoint(s): PFS in subgroups defined by tBRCA status (presence or absence of a deleterious/suspected deleterious mutation), OS (time from randomization to death), TFST (time from randomization to the first subsequent treatment or death, whichever occurs earlier), PFS2 (time from randomization to the second progression or death, whichever occurs earlier), TSST (time from randomization to the second subsequent treatment or death, whichever occurs earlier), Safety and tolerability evaluated by AEs / SAEs, physical examination, vital signs including BP, heart rate, and laboratory findings including clinical chemistry / hematology parameters., Effects on Quality of life (QoL) assessed by EORTC QLQ-C30 (functional and HRQoL scales), QLQ-OV-28 questionnaires (items 31 to 36 from the abdominal/GI symptoms subscale), Patient reported outcomes version of the Common Terminology Criteria for Adverse Events (PRO-CTCAE)

Source: https://euclinicaltrials.eu/ctis-public/view/2024-516066-11-00